EU clinical trial 2023-507757-15-01: C3601010: A Phase 2A, 2-Part, Open-Label, Non-Randomized, Multicenter, Single and Multiple Dose Trial to Evaluate Pharmacokinetics, Safety and Tolerability of Aztreonam and Avibactam ± Metronidazole in Neonates and Infants From Birth to Less Than 9 Months of Age With Suspected or Confirmed Infections Due to Gram-Negative Pathogens Requiring Intravenous Antibiotic Treatment
Protocol code: C3601010
Sponsor: Pfizer Inc. (Pharmaceutical company). Phase: Therapeutic exploratory (Phase II). Countries: Slovakia (ended), Greece (authorised, recruitment pending), Bulgaria (authorised, recruitment pending), Italy (authorised, recruitment pending), Hungary (ended), Spain (authorised, recruitment pending).
Therapeutic area(s): Diseases [C] - Bacterial Infections and Mycoses [C01]
Gender: Female, Male. Age: 0-17 years. Enrolment: 18.
Decision date: 2025-04-30. Results received: No. Last updated: 2026-06-26.
Decision dates by country: HU: 2025-05-06, SK: 2025-04-30, ES: 2025-10-03, IT: 2025-04-30, GR: 2025-04-30, BG: 2025-05-02

Condition(s): Blood Stream Infection, Sepsis, Complicated Urinary Tract Infection, Suspected or Confirmed Infections Due to Gram-Negative Pathogens Requiring Intravenous Antibiotic Treatment, Hospital-acquired pneumonia or ventilator-associated pneumonia, Complicated Intra-abdominal Infection
Product: Metronidazole, Aztreonam and Avibactam (1.5g/0.5g) Powder for Concentrate for Solution for Infusion, Metronidazole 500 mg / 100 ml Intravenous Infusion, Metronidazole 500mg/100ml Solution for Infusion

Primary endpoint: PK parameters including clearance (CL), maximum plasma concentration (Cmax), area under the plasma concentration time curve (AUC) and half-life (t1/2), Plasma concentrations of ATM and AVI on Day 1 and at steady state (Day 2 or later), Adverse events (AEs) and Serious Adverse Events (SAEs), Adverse events leading to discontinuation and adverse events resulting in death, Assessments of liver and renal functions tests at baseline, while on treatment and after end of treatment
Endpoint(s): Clinical outcomes at End of Intravenous Treatment (EOIV), End of Treatment (EOT), and Test of Cure (TOC). (Pat B only), Per-pathogen microbiological response at EOIV/EOT, and TOC., Per-participant microbiological response at TOC, Emergent infection

Source: https://euclinicaltrials.eu/ctis-public/view/2023-507757-15-01